EU clinical trial 2022-501696-91-00: Dosimetry of a novel amino acid PET tracer, [18F]FELP
Protocol code: NGF1
Sponsor: Universitair Ziekenhuis Gent (Hospital/Clinic/Other health care facility). Phase: Human Pharmacology (Phase I)- First administration to humans. Countries: Belgium (temporarily halted).
Therapeutic area(s): Diseases [C] - Neoplasms [C04]
Gender: Female, Male. Age: 18-64 years, 65+ years. Enrolment: 10.
Status: Temporarily halted. Start date (EU): 2024-04-10. Decision date: 2023-10-27. Results received: No. Last updated: 2025-04-11.

Condition(s): Glioblastoma

Source: https://euclinicaltrials.eu/ctis-public/view/2022-501696-91-00